EU clinical trial 2024-518344-20-00: The efficacy and safety of Intramuscular Methylprednisolone in patients with Hand OsteoArthritis: the IMHOA trial
Sponsor: Sint Maartenskliniek Stichting (Hospital/Clinic/Other health care facility). Phase: Therapeutic confirmatory (Phase III). Countries: Netherlands (authorised, recruiting).
Therapeutic area(s): Diseases [C] - Immune System Diseases [C20]
Gender: Female, Male. Age: 18-64 years, 65+ years. Enrolment: 212.
Status: Authorised, recruiting. Start date (EU): 2025-10-28. Decision date: 2025-09-04. Results received: No. Last updated: 2026-06-02.

Condition(s): Hand osteoarthritis
Product: Natriumchloride 0,9% oplossing voor injectie, Depo-Medrol 40 mg/ml, suspensie voor injectie

Primary endpoint: The primary objective of this study is to assess the efficacy of intramuscular methylprednisolone acetate (120mg or 40mg) in reducing hand pain between baseline and week 4, compared to placebo measured on a digital 100mm Visual Analogue Scale (VAS).
Endpoint(s): Evaluate the non-inferiority of 40mg MP compared to 120mg MP, provided both doses demonstrate superiority over placebo., Compare the three treatment arms based on hand pain reduction, functional improvement, grip strength, quality of life, and systemic/local inflammation changes over 48 weeks., Assessments based on patient-reported outcomes, structural joint changes via imaging, and inflammatory biomarkers., The exploration of predictors of treatment response, subgroup variations based on radiographic findings, and safety outcomes using standardized criteria., The efficacy and safety of MP will be analysed concerning cumulative dose and circulating biomarkers.

Source: https://euclinicaltrials.eu/ctis-public/view/2024-518344-20-00